EU clinical trial 2024-514565-18-00: DASL-HiCaP: Darolutamide Augments Standard Therapy for Localised Very High-Risk Cancer of the Prostate (ANZUP1801). A randomised phase 3 double-blind, placebo-controlled trial of adding darolutamide to androgen deprivation therapy and definitive or salvage radiation in very high risk, clinically localised prostate cancer.
Sponsor: Cancer Trials Ireland (Patient organisation/association). Phase: Therapeutic confirmatory (Phase III). Countries: Ireland (ongoing, recruitment ended).
Therapeutic area(s): Diseases [C] - Neoplasms [C04]
Gender: Male. Age: 18-64 years, 65+ years. Enrolment: 36.
Status: Ongoing, recruitment ended. Start date (EU): 2021-07-20. Decision date: 2024-07-29. Results received: No. Last updated: 2026-03-31.

Condition(s): Localised Very High-Risk Cancer of the Prostate
Product: NUBEQA 300 mg film-coated tablets, Placebo to BAY1841788 film-coated tablet 300 mg

Primary endpoint: Metastasis-free Survival (MFS)
Endpoint(s): Overall Survival (OS), Prostate cancer-specific Survival, PSA Progression-free Survival, Time to Subsequent Hormonal Therapy, Time to Castration Resistance (PCWG3 criteria), Frequency and severity of adverse events, Health Related Quality of Life (HRQL), Fear of Cancer Recurrence, Incremental cost-effectiveness, Prognostic/predictive biomarkers

Source: https://euclinicaltrials.eu/ctis-public/view/2024-514565-18-00